EU clinical trial 2025-524725-41-00: Single-centre Phase I/II study with dose escalation of tocilizumab in combination with venetoclax and azacitidine chemotherapy in patients with Acute Myeloid Leukaemia (AML): TOCIVENA
Protocol code: RC25_0533
Sponsor: Centre Hospitalier Universitaire De Nantes (Hospital/Clinic/Other health care facility). Phase: Human Pharmacology (Phase I)- Other. Countries: France (authorised, recruitment pending).
Therapeutic area(s): Not possible to specify
Gender: Female, Male. Age: 18-64 years, 65+ years. Enrolment: 12.
Status: Authorised, recruitment pending. Decision date: 2026-04-10. Results received: No. Last updated: 2026-04-10.

Condition(s): Acute Myeloblastic Leukemia

Source: https://euclinicaltrials.eu/ctis-public/view/2025-524725-41-00